EU clinical trial 2022-500743-20-00: "TUC-TOC": Tucatinib in combination with Oral Etoposide (VP16) - Trastuzumab in Patients with metastatic HER2+ Breast cancer after progression under Tucatinib-Capecitabine-Trastuzumab or toxicity related to capecitabine: a multicenter Phase II
Protocol code: IC 2021-06
Sponsor: Institut Curie (Hospital/Clinic/Other health care facility). Phase: Therapeutic exploratory (Phase II). Countries: France (ongoing, recruiting).
Therapeutic area(s): Diseases [C] - Neoplasms [C04]
Gender: Female. Age: 18-64 years, 65+ years. Enrolment: 66.
Status: Ongoing, recruiting. Start date (EU): 2023-12-19. Decision date: 2023-06-26. Results received: No. Last updated: 2025-02-27.

Condition(s): Metastatic HER2+ Breast cancer
Product: TUKYSA 50 mg film-coated tablets, TUKYSA 150 mg film-coated tablets, Herceptin 150 mg powder for concentrate for solution for infusion, CELLTOP 50 mg – Weichkapseln, Herceptin 600 mg solution for injection in vial

Primary endpoint: The objective response rate (ORR) is defined as the best response defined as complete or partial response occurring within the first 6 months of treatment, assessed by the investigators (according to RECIST v1.1 criteria)
Endpoint(s): Serious adverse events (SAEs) and adverse events (AEs) according to NCI CTCAE v5.0, by grade and their relationship to tucatinib-Oral VP16-trastuzumab, Progression free survival (PFS) is defined as the time from the date of inclusion until progression per RECIST 1.1 as assessed by the investigator at local site or death due to any cause. The measure of interest is the median PFS, Overall survival (OS) is defined as the time from inclusion to the date of death due to any cause. The measure of interest is the median OS (if reached)., Duration of response (DoR) as defined as the time from the date of first documented response until date of documented progression per RECIST 1.1 as assessed by the investigator at local site or death due to any cause. The measure of interest is the median DoR, Time to response (TTR) as defined as the time from the start of treatment to the first ORR observed for patients who achieved a CR or PR. The measure of interest is the median TTR, Clinical benefit rate (CBR) is defined as the percentage of patients with CR, PR, or stable disease (SD) according to RECIST 1.1, as assessed by the investigator at the local site. The measure of interest is CBR at 24 weeks, The measure of interest is the mean difference in the change from baseline in EQ-5D-5L scale. Time to deterioration in pain, physical functioning, role functioning and global health status/QoL., Proportion of patients alive and without progression at 6 months, Progression free survival (PFS) and Overall survival (OS) as defined above are compared between predefined subgroups: - Patients who progressed on prior tucatinib-trastuzumab-capecitabine therapy or have documented/anticipated capecitabine-related toxicity and patients without progression or toxicity. - Patient characteristics (patients with or without brain metastasis), Exploratory: Pharmacokinetic assessments of oral VP16 (day 1, 14, 21) and tucatinib (day 14, 21) and will be performed in the safety run-in part (i.e.., the patients included in the first part), Exploratory: Baseline ctDNA levels (C1) and change at 3 weeks (C2) and at progression (optional): amount, mutation status and expression level of cancer associated genes in ctDNA by NGS panel, Exploratory: TOP2A and HER2 co amplification will be performed by ShallowWGS using FFPE tumor tissue

Source: https://euclinicaltrials.eu/ctis-public/view/2022-500743-20-00